EU clinical trial 2024-513955-34-00: A pilot, multicentre, controlled, open-label study evaluating 24 months of lithium carbonate treatment in patients with TBR1-related neurocognitive disorder. ESALIT (Efficacy- Safety-Lithium-TBR1)
Protocol code: ESALIT
Sponsor: Centre Hospitalier Universitaire De Dijon (Hospital/Clinic/Other health care facility). Phase: Phase I and Phase II (Integrated)- Other. Countries: France (ongoing, recruiting).
Therapeutic area(s): Phenomena and Processes [G] - Genetic Phenomena [G05]
Gender: Female, Male. Age: 0-17 years, 18-64 years, 65+ years. Enrolment: 12.
Status: Ongoing, recruiting. Start date (EU): 2025-09-09. Decision date: 2024-12-11. Results received: No. Last updated: 2026-05-11.

Condition(s): Proven pathogenic or probably pathogenic TBR1 variant
Product: TERALITHE 250 mg, comprimé sécable, carbonate de lithium

Primary endpoint: Clinical response defined as an improvement at the end of the 24 months of lithium carbonate treatment in the Vineland II Adaptive Behaviour Scale (VABS-II) score ≥ standard error of the mean (SEM) of the VABS-II at baseline (end of the observational period).
Endpoint(s): 1. Incidence and severity of lithium related adverse events (AE) using the CTCAE V5.0., 2. Improvement ≥ SEM of the VABS-II at baseline (end of the observational period), in socialization subscale and communication subscale standard scores of the VABS-II after 24 months of lithium carbonate treatment., 3. Clinical response defined as an improvement ≥ SEM of the VABS-II at baseline (end of the observational period) after 6 months of treatment compared with untreated patients., 4. Change in score of QoL assessed by the Paediatric Quality of Life Inventory 4.0 (PedSQL) or the San Martin Quality of Life scale after 6, 12, 18 and 24 months of lithium carbonate treatment., 5. Clinical response defined as an improvement ≥ SEM of the VABS-II at baseline (end of the observational period) at 12 and 18 months of lithium treatment., 6. Evolution of number of seizures clinic or infra-clinic and/or brain activity as measured by EEG whenever appropriate after 24 months of lithium carbonate treatment., EXPLORATORY ENDPOINTS: 1. Difference in socialization subscale and communication subscale standard scores of the VABS-II after 6, 12 and 18 months of lithium carbonate treatment., EXPLORATORY ENDPOINTS: 2. Difference in reasoning and inhibition abilities assessed the 3 reasoning tasks on tablet of increasing difficulty(measured by reaction Time and Error Rate analysis) after 6, 12, 18 and 24 months of lithium carbonate treatment., EXPLORATORY ENDPOINTS: 3. Change in scores of Aberrant Behaviour Checklist (ABC) questionnaire in children and adults, of Child Behaviour Checklist (CBCL) scale in children, of Adult Behaviour Checklist (ABCL) scale in adults after 6, 12, 18 and 24 months of lithium carbonate treatment., EXPLORATORY ENDPOINTS: 4. Change in scores of Clinical Global Impression scale (CGI), after 6, 12, 18 and 24 months of lithium carbonate treatment., EXPLORATORY ENDPOINTS: 5. Change in scores of Wechsler Scale or Leiter-3 according to the investigator's assessment of the disability (WISC-V in children aged 6 to 16 years, WAIS-IV in children older than 16 years; Leiter 3 in patients aged 3 to 75 years with no language skills and moderate to severe ID) after 24 months of lithium carbonate treatment., EXPLORATORY ENDPOINTS: 6. Change in scores of Pervasive Development Disorder in Mentally Retarded persons Scales (PDD-MRS) and Autism Diagnostic Observation Schedule (ADOS II) in children and adults after 12 and 24 months of lithium carbonate treatment, EXPLORATORY ENDPOINTS : Saturation of empirical data obtained through individual interviews on parents’/caregivers’ expectations regarding the clinical trial., EXPLORATORY ENDPOINTS : Saturation of the empirical data obtained through individual interviews on parents’/caregivers’ perception of the treatment’s effectiveness particularly with regard to the expectations that were expressed

Source: https://euclinicaltrials.eu/ctis-public/view/2024-513955-34-00